EU clinical trial 2024-511032-27-00: Short-Term Linvoseltamab Treatment, on Top of Chronic Dupilumab Treatment, for Adults with Severe Immunoglobulin E (IgE)-Mediated Food Allergy
Protocol code: R5458-668-ALG-2219
Sponsor: Regeneron Pharmaceuticals Inc. (Pharmaceutical company). Phase: Human Pharmacology (Phase I)- Other. Countries: Spain (ended).
Therapeutic area(s): Diseases [C] - Immune System Diseases [C20]
Gender: Female, Male. Age: 18-64 years. Enrolment: 3.
Status: Ended. End date (EU): 2025-08-11. Decision date: 2024-06-11. Results received: No. Last updated: 2024-12-13.

Condition(s): Severe IgE-mediated food allergy

Source: https://euclinicaltrials.eu/ctis-public/view/2024-511032-27-00